EU clinical trial 2024-518694-33-00: The Italian Cohort (ITACO) and the Analytical Antiretroviral Treatment Interruption Italian Cohort (ITACO-ATI) study guided by molecular HIV-1 reservoir profiling
Protocol code: ITACO_2780_OPBG_2022
Sponsor: Ospedale Pediatrico Bambino Gesu (Hospital/Clinic/Other health care facility). Phase: Therapeutic confirmatory (Phase III). Countries: Italy (ended).
Therapeutic area(s): Diseases [C] - Immune System Diseases [C20]
Gender: Female, Male. Age: 0-17 years, 18-64 years. Enrolment: 61.
Status: Ended. Start date (EU): 2023-08-08. End date (EU): 2026-04-02. Decision date: 2025-01-31. Results received: No. Last updated: 2025-07-24.

Condition(s): perinatally HIV infection
Product: EMTRICITABINE AND TENOFOVIR ALAFENAMIDE, DARUNAVIR AND COBICISTAT, LAMIVUDINE AND DOLUTEGRAVIR, EMTRICITABINE, TENOFOVIR ALAFENAMIDE, DARUNAVIR AND COBICISTAT, DOLUTEGRAVIR, LAMIVUDINE, ABACAVIR AND DOLUTEGRAVIR, LAMIVUDINE, RILPIVIRINE, EMTRICITABINE, TENOFOVIR ALAFENAMIDE AND BICTEGRAVIR, EMTRICITABINE, TENOFOVIR ALAFENAMIDE AND RILPIVIRINE

Primary endpoint: 1. ITACO cohort: Proportion of patients with absence or HIV intact proviruses, isolated from at least 20 million peripheral blood mononuclear cells (PBMCs), located in heterochromatin positions, which include (i) all non-genic positions, (ii) positions in ZNF genes on chromosome 19, which display extensive binding to heterochromatin proteins and associated with repressive histone modifications (PredictHIV negative) 2. ITACO-ATI cohort: Proportion of patients “PredictHIV negative” who underwent A
Endpoint(s): 1. ITACO cohort: • Proportion of patients with virus inducibility (TILDA assay) in the whole cohort and with distinct latency reversal agents (LRAs) in vitro • Proportion of patients with GALT with absence of intact HIV provirus • Adverse events and serious adverse events 2. ITACO-ATI cohort: • Time from ART discontinuation (start of ATI) to HIV RNA rebound to ≥ 1,000 copies/mL. • Time from ART discontinuation to meeting criteria for ART re-initiation. • Proteomic and In Vitro Gene Expre

Source: https://euclinicaltrials.eu/ctis-public/view/2024-518694-33-00